EU clinical trial 2026-525658-13-00: A multicentre, adaptive, randomised, multidomain, platform trial for dose optimization in the treatment of adult patients with haematological diseases (BLOOD-dose): core protocol
Protocol code: BLOOD-dose-001
Sponsor: Region Hovedstaden (Hospital/Clinic/Other health care facility). Phase: Therapeutic use (Phase IV). Countries: Denmark (authorised, recruitment pending).
Therapeutic area(s): Diseases [C] - Hemic and Lymphatic Diseases [C15]; Diseases [C] - Neoplasms [C04]
Gender: Female, Male. Age: 18-64 years, 65+ years. Enrolment: 200.
Status: Authorised, recruitment pending. Decision date: 2026-06-25. Results received: No. Last updated: 2026-06-25.

Condition(s): Haematological diseases; any disorder that primarily affects the blood, bone marrow, the lymphatic system and/or blood-forming organs.
Product: IBRUTINIB, LYNOZYFIC 5 mg concentrate for solution for infusion, ELREXFIO 40 mg/mL solution for injection, ZANUBRUTINIB, TECVAYLI 10 mg/mL solution for injection, TALVEY 2 mg/mL solution for injection

Primary endpoint: Overall survival (OS)
Endpoint(s): Progression free survival (PFS), Patient-reported health-related quality of life (HRQoL), Number and type, seriousness and relationship to study treatments of AEs, vital signs, and clinical laboratory results, as indicated in the DSA., Planned hospital admission with no emergency room visit; Unplanned hospital admission with no emergency room visit and with emergency room visit; Length of hospital stay; Length of any time spent in an intensive care unit; mergency room visit only; Outpatient/physician office attendance; Physician/nurse telephone contact visit, Exposure to trial medicinal products; Treatment duration

Source: https://euclinicaltrials.eu/ctis-public/view/2026-525658-13-00